EU clinical trial 2023-507699-38-00: A Phase 3 Open-Label, Randomized Study of Pirtobrutinib (LOXO-305) versus Ibrutinib in Patients with Chronic Lymphocytic Leukemia/Small Lymphocytic Lymphoma (BRUIN-CLL-314)
Protocol code: LOXO-BTK-20030
Sponsor: Loxo Oncology Inc. (Pharmaceutical company). Phase: Therapeutic confirmatory (Phase III). Countries: Hungary (ongoing, recruiting), Czechia (ongoing, recruitment ended), Italy (ongoing, recruiting), Austria (ended), Germany (ongoing, recruiting), Spain (ongoing, recruiting), Belgium (ongoing, recruitment ended), Poland (ongoing, recruiting), France (ongoing, recruiting).
Therapeutic area(s): Diseases [C] - Neoplasms [C04]
Gender: Female, Male. Age: 18-64 years, 65+ years. Enrolment: 377.
Start date (EU): 2022-08-30. Decision date: 2024-04-26. Results received: No. Last updated: 2026-07-27.
Decision dates by country: AT: 2024-05-06, HU: 2024-04-26, ES: 2024-04-26, IT: 2024-05-03, FR: 2024-04-26, CZ: 2024-05-02, DE: 2024-05-03, BE: 2024-05-07, PL: 2024-05-20

Condition(s): Chronic Lymphocytic Leukemia/Small Lymphocytic Lymphoma
Product: IBRUTINIB, PIRTOBRUTINIB, PIRTOBRUTINIB

Primary endpoint: Part 1 and Part 2: Primary endpoint: Overall response rate (ORR) as assessed by independent review committee (IRC) per iwCLL 2018 criteria. ORR is defined as the proportion of patients who achieve a BOR of CR, CRi, nPR, or PR at or before the initiation of subsequent anticancer therapy.

Source: https://euclinicaltrials.eu/ctis-public/view/2023-507699-38-00